EU clinical trial 2024-516682-36-00: 18F-Fluorocholine (FCH) versus 18F-Fluorodesoxyglucose (FDG) PET/CT for the detection of lesions in patients with multiple myeloma
Sponsor: Centr Georges Francois Leclerc (Hospital/Clinic/Other health care facility). Phase: Therapeutic exploratory (Phase II). Countries: France (ongoing, recruitment ended).
Therapeutic area(s): Diseases [C] - Immune System Diseases [C20]
Gender: Female, Male. Age: 18-64 years, 65+ years. Enrolment: 38.
Status: Ongoing, recruitment ended. Start date (EU): 2020-12-15. Decision date: 2024-08-23. Results received: No. Last updated: 2024-08-23.

Condition(s): Patients diagnosed with multiple myeloma

Source: https://euclinicaltrials.eu/ctis-public/view/2024-516682-36-00